EU clinical trial 2024-516063-89-00: RASolute 302: A Phase 3 Multicenter, Open-label, Randomized Study of RMC-6236 versus Investigator’s Choice of Standard of Care Therapy in Patients with Previously Treated Metastatic Pancreatic Ductal Adenocarcinoma (PDAC)
Protocol code: RMC-6236-302
Sponsor: Revolution Medicines Inc. (Pharmaceutical company). Phase: Therapeutic confirmatory (Phase III). Countries: Italy (ongoing, recruitment ended), Germany (ongoing, recruitment ended), Spain (ongoing, recruitment ended), France (ongoing, recruitment ended).
Therapeutic area(s): Diseases [C] - Neoplasms [C04]
Gender: Female, Male. Age: 18-64 years, 65+ years. Enrolment: 136.
Status: Ongoing, recruitment ended. Start date (EU): 2025-04-10. Decision date: 2024-12-13. Results received: No. Last updated: 2026-08-03.
Decision dates by country: ES: 2025-01-24, IT: 2024-12-17, DE: 2024-12-16, FR: 2025-01-24

Condition(s): Metastatic Pancreatic Ductal Adenocarcinoma
Product: DARAXONRASIB (RMC-6236), PACLITAXEL ALBUMIN-BOUND, GEMCITABINE HYDROCHLORIDE, IRINOTECAN HYDROCHLORIDE, IRINOTECAN, FOLINIC ACID, GEMCITABINE HYDROCHLORIDE, DARAXONRASIB (RMC-6236), FLUOROURACIL, GEMCITABINE HYDROCHLORIDE, GEMCITABINE HYDROCHLORIDE, OXALIPLATIN, GEMCITABINE HYDROCHLORIDE, GEMCITABINE HYDROCHLORIDE

Primary endpoint: PFS is defined as the time from randomization until disease progression or death from any cause, whichever occurs first. Progression is per RECIST v1.1 and as assessed by BICR. OS is defined as the time from randomization until death from any cause.

Source: https://euclinicaltrials.eu/ctis-public/view/2024-516063-89-00